EU clinical trial 2023-505316-37-00: A double-blind, randomized, placebo-controlled, dose-finding phase II study to assess the efficacy and safety of pasireotide s.c. in patients with Post-Bariatric Hypoglycaemia
Protocol code: SOM230-RECAG-CL-0576
Sponsor: Recordati AG (Pharmaceutical company). Phase: Therapeutic exploratory (Phase II). Countries: Belgium (ended), France (ongoing, recruitment ended), Spain (ongoing, recruitment ended), Italy (ended).
Therapeutic area(s): Diseases [C] - Nutritional and Metabolic Diseases [C18]
Gender: Female, Male. Age: 18-64 years, 65+ years. Enrolment: 30.
Start date (EU): 2024-06-13. Decision date: 2024-05-13. Results received: No. Last updated: 2026-01-05.
Decision dates by country: BE: 2024-05-13, FR: 2024-05-21, IT: 2024-05-15, ES: 2024-05-14

Condition(s): Post-Bariatric Hypoglycaemia

Primary endpoint: Change in the blood glucose levels, as measured by the peak to nadir glucose AUC, during the MMTT at baseline to the MMTT at 12 weeks of treatment with pasireotide s.c. 50 µg, or 100 µg or 200 µg tid vs placebo tid.
Endpoint(s): Secondary and exploratory – For the Core phase Key secondary endpoint: 1. Change from baseline in the rate of the composite (and individual components) of clinically significant hypoglycaemic events as measured as the frequency of level 2 hypoglycaemic events (glucose level <54 mg/dL or 3.0 mmol/L) measured by SMBG OR the frequency of level 3 hypoglycaemic (requiring external assistance) events/4-weeks at 12 weeks of treatment with pasireotide s.c. 50 µg, or 100 µg or 200 µg tid vs placebo tid., Secondary endpoints: 1. Change in the nadir and peak of blood glucose levels, during the MMTT at baseline to the MMTT at 12 weeks of treatment with pasireotide s.c. 50 µg, or 100 µg or 200 µg tid vs placebo tid, 2. Change from baseline in the proportion of patients with no level 2 hypoglycaemic events (plasma glucose <54 mg/dL or 3.0 mmol/L) at 60, 90, 105, 120, 135, 150, 165 and 180 min during a 3-hour MMTT after 12 weeks of treatment with pasireotide s.c. 50 µg, or 100 µg or 200 µg tid or vs placebo tid respectively, 3. Changes in HRQoL (SF-36 score, Hypoglycaemia Fear Survey-II, Dumping Score Questionnaire and Patient Global Assessment) from baseline to week 12 of treatment with pasireotide s.c. 50, or 100 or 200 µg tid or placebo tid, 4. Incidence of AEs, laboratory, and ECG findings at pasireotide s.c. 50 µg, or 100 µg or 200 µg tid or placebo tid. Changes from baseline in laboratory values, ECG readings, gallbladder imaging and in vital signs, Exploratory endpoints: 1. Change from baseline in the rate of the composite (and individual components) of clinically significant hypoglycaemic events as measured as the frequency of level 2 hypoglycaemic events (glucose level <54 mg/dL or 3.0 mmol/L) measured by SMBG OR the frequency of level 3 hypoglycaemic (requiring external assistance) events/4-weeks at 4 and 8 weeks of treatment with pasireotide s.c. 50 µg, or 100 µg or 200 µg tid vs placebo tid, 2. Change from baseline in the rate of level 2 hypoglycaemic events (glucose level <54 mg/dL or 3.0 mmol/L for at least 15 minutes) including the overall, diurnal and nocturnal events measured by CGM at 4, 8 and 12 weeks of treatment with pasireotide s.c. 50 µg, or 100 µg or 200 µg tid vs placebo tid, 3. Change from baseline in duration of Level 2 hypoglycaemic events (glucose level <54 mg/dL or 3.0 mmol/L for at least 15 minutes), including the overall, diurnal and nocturnal events by CGM at 4, 8, and 12 weeks of treatment with pasireotide s.c. 50, or 100 or 200 µg tid or placebo tid, 4. Change from baseline in percent time with Level 2 hypoglycaemic events (glucose level <54 mg/dL or 3.0 mmol/L for at least 15 min) including the overall, diurnal and nocturnal events by CGM at 4, 8, and 12 weeks of treatment with pasireotide s.c. 50, or 100 or 200 µg tid or placebo tid, 5. Absolute and percent changes in insulin, glucagon and GLP-1 secretion from baseline during the MMTT after 12 weeks of treatment with pasireotide s.c. 50 µg, or 100 µg or 200 µg tid or placebo tid, 6. Change from baseline in the frequency of use of rescue therapy and/or rescue carbohydrates at home to manage Level 2 or Level 3 hypoglycaemic events at 4, 8, and 12 weeks of treatment with pasireotide s.c. 50 µg, or 100 µg or 200 µg tid vs placebo tid, 7. Proportion of participants with change in pulse rate <10 bpm during the MMTT after 12 weeks of treatment with pasireotide s.c. 50 µg, or 100 µg or 200 µg tid or placebo tid, 8. Proportion of participants with change in haematocrit <3% during the MMTT after 12 weeks of treatment with pasireotide s.c. 50 µg, or 100 µg or 200 µg tid or placebo tid, Secondary and Exploratory endpoints For the Extension Phase. Secondary For the Extension phase 1. Incidence of AEs, laboratory, and ECG findings with pasireotide s.c. tid. Changes from baseline in laboratory values, ECG readings, gallbladder imaging and in vital signs during the whole extension period, Exploratory For the Extension phase 1. Change in the blood glucose levels, as measured by the peak to nadir glucose AUC, during the MMTT at baseline to the MMTT at 24 weeks of treatment with pasireotide s.c. tid., 2. Change from baseline in the rate of the composite (and individual components) of clinically significant hypoglycaemic events as measured as the frequency level 2 hypoglycaemic events (glucose level <54 mg/dL or 3.0 mmol/L) measured by SMBG or Level 3 hypoglycaemic events (requiring external assistance) at weeks 16, 20, 24, 32, 40 and 48 of treatment with pasireotide s.c. tid, 3. Change in the nadir and the peak of blood glucose levels, during the MMTT at baseline to the MMTT at 24 weeks of treatment with pasireotide s.c. tid, 4. Change from baseline in the proportion of patients with no level 2 hypoglycaemic events (plasma glucose <54 mg/dL or 3.0 mmol/L) at 60, 90, 105, 120, 135, 150, 165 and 180 min during a 3-hour MMTT after 24 weeks of treatment with pasireotide s.c. tid, 5. Changes in HRQoL (SF-36 score, Dumping Score Questionnaire, Hypoglycaemia Fear Survey-II and Patient Global Assessment) from baseline with pasireotide s.c. tid at weeks 24 and 48 of treatment, 6. Change from baseline in the rate of level 2 hypoglycaemic events (blood glucose <54 mg/dL or 3.0 mmol/L for at least 15 minutes) including the overall, diurnal and nocturnal events by CGM with pasireotide s.c. tid at weeks 16, 20, 24, 32, 40 and 48 of treatment, 7. Change from baseline in duration of Level 2 hypoglycaemic events (glucose level <54 mg/dL or 3.0 mmol/L for at least 15 minutes) including the overall, diurnal and nocturnal events by CGM with pasireotide s.c. tid at weeks 16, 20, 24, 32, 40 and 48 of treatment, 8. Change from baseline in percent time with Level 2 hypoglycaemic events (glucose level <54 mg/dL or 3.0 mmol/L for at least 15 minutes) including the overall, diurnal and nocturnal events by CGM with pasireotide s.c. tid at weeks 16, 20, 24, 32, 40 and 48 of treatment, 9. Absolute and percent changes in insulin, glucagon and GLP-1 secretion from baseline during the MMTT after 24 weeks of treatment with pasireotide s.c. tid, 10. Change from baseline in the frequency of use of rescue therapy and/or rescue carbohydrates at home to manage Level 2 or Level 3 hypoglycaemic events during treatment with pasireotide s.c. tid at weeks 16, 20, 24, 32, 40 and 48 of treatment, 11. Proportion of participants with change in pulse rate <10 bpm during the MMTT at 24 weeks of treatment with pasireotide s.c. tid, 12. Proportion of participants with change in haematocrit <3% during the MMTT 24 weeks of treatment with pasireotide s.c. tid

Source: https://euclinicaltrials.eu/ctis-public/view/2023-505316-37-00